EU clinical trial 2024-511281-36-00: A double-blind, randomized, placebo-controlled study to assess the safety and efficacy of nebulized PC945 when added to systemic antifungal therapy for the treatment of refractory invasive pulmonary aspergillosis (OPERA-T study)
Protocol code: PC_ASP_006
Sponsor: Pulmocide Limited (Pharmaceutical company). Phase: Therapeutic confirmatory (Phase III). Countries: Spain (ended), Austria (ended), Belgium (ended), Italy (ended), Greece (ended), France (ended), Germany (ended).
Therapeutic area(s): Diseases [C] - Bacterial Infections and Mycoses [C01]
Gender: Female, Male. Age: 18-64 years, 65+ years. Enrolment: 46.
Status: Ended. Start date (EU): 2022-11-17. End date (EU): 2025-12-19. End date: 2025-12-30. Decision date: 2024-12-06. Results received: Yes. Last updated: 2025-09-05.
Decision dates by country: FR: 2025-01-13, AT: 2024-12-11, GR: 2025-01-23, ES: 2024-12-09, BE: 2024-12-06, DE: 2024-12-10, IT: 2024-12-11

Condition(s): Refractory Invasive Pulmonary Aspergillosis
Product: PC945, PC945 Placebo Nebuliser Liquid

Primary endpoint: Number of Participants with Complete or Partial Overall Response up to 12 Weeks (Day 84)
Endpoint(s): Time to Complete or Partial Overall Clinical Response up to 12 Weeks (Day 84)

Source: https://euclinicaltrials.eu/ctis-public/view/2024-511281-36-00